EU clinical trial 2024-518990-33-00: Multicentre, randomised, double-blind, parallel-group, Phase III study to evaluate the genetic polymorphisms influence in the response to Ranibizumab and Bevacizumab treatment in patients with Age-Associated Macular Degeneration
Sponsor: Consorci Mar Parc De Salut De Barcelona (Hospital/Clinic/Other health care facility). Phase: Phase III and phase IV (Integrated). Countries: Spain (ongoing, recruitment ended).
Therapeutic area(s): Diseases [C] - Eye Diseases [C11]
Gender: Female, Male. Age: 18-64 years. Enrolment: 574.
Status: Ongoing, recruitment ended. Start date (EU): 2024-10-25. Decision date: 2024-10-25. Results received: No. Last updated: 2025-06-26.

Condition(s): Age-Associated Macular Degeneration
Product: Avastin 25 mg/ml concentrate for solution for infusion., RANIBIZUMAB

Primary endpoint: Visual acuity score measured on ETDRS at 4 meters of initial distance or Snellen with conversion to ETDRS if necessary, using the method proposed by Rosenfeld et al, between the baseline and final evaluations. Main outcome will be assessed at 1 year.Genetic polymorphism: Saliva samples will be collected using oral swabs suitable for obtaining DNA. The genomic DNA will be obtained from a first digestion of the sample wit

Source: https://euclinicaltrials.eu/ctis-public/view/2024-518990-33-00